EU clinical trial 2025-520565-51-00: DAREON®-Lung-1: A Phase III multi-center, open-label, randomised trial of intravenous obrixtamig in combination with atezolizumab, carboplatin, and etoposide vs. atezolizumab, carboplatin, and etoposide as first-line treatment in patients with extensive-stage small cell lung cancer.
Protocol code: 1438-0012
Sponsor: Boehringer Ingelheim International GmbH, Boehringer Ingelheim Espana S.A. (Pharmaceutical company). Phase: Therapeutic confirmatory (Phase III). Countries: Czechia (authorised, recruitment pending), Sweden (authorised, recruiting), Poland (authorised, recruitment pending), Netherlands (authorised, recruiting), Greece (authorised, recruitment pending), Latvia (authorised, recruitment pending), Finland (authorised, recruitment pending), Norway (authorised, recruitment pending), Belgium (authorised, recruitment pending), Austria (authorised, recruitment pending), Portugal (authorised, recruiting), Romania (authorised, recruitment pending), Italy (authorised, recruitment pending), Estonia (authorised, recruitment pending), France (ongoing, recruiting), Ireland (authorised, recruitment pending), Germany (ongoing, recruiting), Spain (ongoing, recruiting), Bulgaria (authorised, recruitment pending), Hungary (authorised, recruitment pending).
Therapeutic area(s): Diseases [C] - Neoplasms [C04]
Gender: Female, Male. Age: 18-64 years, 65+ years. Enrolment: 295.
Start date (EU): 2026-06-23. Decision date: 2026-05-12. Results received: No. Last updated: 2026-08-03.
Decision dates by country: BE: 2026-05-12, EE: 2026-05-18, FR: 2026-05-18, DE: 2026-05-12, IE: 2026-05-15, PT: 2026-05-14, RO: 2026-05-18, NL: 2026-05-18, NO: 2026-05-18, AT: 2026-05-17, BG: 2026-05-18, CZ: 2026-05-13, GR: 2026-05-13, HU: 2026-05-15, IT: 2026-05-13, LV: 2026-05-13, PL: 2026-05-15, SE: 2026-05-13, ES: 2026-05-29, FI: 2026-05-13

Condition(s): small cell lung cancer
Product: RoActemra 20 mg/mL concentrate for solution for infusion, Tecentriq 1 200 mg concentrate for solution for infusion, BI 764532, Etoposid Hikma 20 mg/ml Konzentrat zur Herstellung einer Infusionslösung, Carboplatin Hikma 10 mg/ml Konzentrat zur Herstellung einer Infusionslösung

Primary endpoint: Overall survival.
Endpoint(s): PFS, defined as the time from randomisation until the earliest date of tumour progression according to the Response Evaluation Criteria in Solid Tumours (RECIST) version 1.1 based on investigator assessments or death from any cause., Change from baseline to Week 19 in the dyspnea symptom subscale of the EORTC QLQ-LC13., OR, defined as a best overall response of complete response (CR) or partial response (PR) according to RECIST 1.1 (based on investigator assessments) from the date of randomisation until the earliest date of disease progression, death, last evaluable tumour assessment before start of subsequent anti-cancer therapy, lost to follow-up, or withdrawal of consent., Occurrence of treatment-emergent CRS during the on-treatment period., Occurrence of treatment-emergent ICANS during the on-treatment period., Occurrence of treatment-emergent AEs leading to trial medication discontinuation during the on-treatment period., Occurrence of treatment-emergent AEs leading to trial medication dose delay during the on-treatment period., Occurrence of treatment-emergent AEs leading to trial medication dose reduction during the on-treatment period., Time to deterioration (TTD), defined as time from randomisation to deterioration maintained for 2 consecutive assessments or 1 assessment followed by death from any cause within 3 weeks for symptom scales: o Dyspnea as measured by EORTC-QLQ-C30 and EORTC-QLQ-LC13 o Chest pain as measured by EORTC-QLQ-LC13 o Cough as measured by EORTC-QLQ-LC13, Change from baseline to Week 19 in symptom scales of the and EORTC QLQ-LC13 o Chest pain as measured by EORTC-QLQ-LC13 o Cough as measured by EORTC-QLQ-LC13

Source: https://euclinicaltrials.eu/ctis-public/view/2025-520565-51-00